EU clinical trial 2023-506026-36-00: Open-label, randomized, assessor-blinded, efficacy, safety, tolerability, and pharmacokinetics study of subcutaneous risankizumab with an adalimumab reference arm in children with active juvenile psoriatic arthritis
Protocol code: M23-732
Sponsor: AbbVie Deutschland GmbH & Co. KG (Pharmaceutical company). Phase: Therapeutic confirmatory (Phase III). Countries: Poland (ongoing, recruiting), Spain (authorised, recruiting), France (authorised, recruiting), Italy (ongoing, recruiting), Germany (authorised, recruiting).
Therapeutic area(s): Diseases [C] - Skin and Connective Tissue Diseases [C17]
Gender: Female, Male. Age: 0-17 years. Enrolment: 24.
Start date (EU): 2024-04-29. Decision date: 2024-03-18. Results received: No. Last updated: 2026-03-17.
Decision dates by country: DE: 2024-03-19, IT: 2024-03-20, FR: 2024-06-11, PL: 2024-03-20, ES: 2024-03-18

Condition(s): Juvenile Psoriatic Arthritis
Product: Humira 40 mg solution for injection in pre-filled syringe, Risankizumab, Humira 20 mg solution for injection in pre-filled syringe, ABBV-066

Primary endpoint: The primary endpoint is the achievement of JIA-ACR 30 response at Week 24.
Endpoint(s): Achievement of JIA-ACR 50/70/90 response at Week 24, Percent change from Baseline in individual components of JIA-CRV at Week 24., Change from Baseline in JADAS-10 and JADAS-27 at Week 24., Achievement of MDA at Week 24 (defined as JADAS-10 of ≤6), Achievement of inactive disease at Week 24 (defined as JADAS-10 of ≤2.7), Change from Baseline in cJADAS-10 and cJADAS-27 at Week 24., Change from Baseline in the Pain-VAS at Week 24, In subjects with PsO (at least 3% BSA at Baseline), achievement of PASI 75/90 at Week 24, In subjects with PsO (at least 3% BSA at Baseline), achievement of the sPGA of PsO of 'clear' or 'almost clear' (0/1) at Week 24., In subjects with PsO (at least 3% BSA at Baseline), change from Baseline in CDLQI at Week 24.

Source: https://euclinicaltrials.eu/ctis-public/view/2023-506026-36-00